EU clinical trial 2024-514544-90-00: Phase I/IIa multicentre phase I/IIa study of infusion of autologous peripheral blood T lymphocytes expanded and genetically modified using Sleeping Beauty family transposons to express a chimeric antigenic receptor with anti-CD19 specificity conjugated to the 4-1BB co-stimulatory and signal-transduction region CD3z and huEGFRt (TranspoCART19) in patients with relapsed or refractory B-cell lymphoma.
Sponsor: Fundacion De Investigacion Biomedica De Salamanca (Laboratory/Research/Testing facility). Phase: Phase I and Phase II (Integrated)- Other. Countries: Spain (ongoing, recruiting).
Therapeutic area(s): Diseases [C] - Neoplasms [C04]
Gender: Female, Male. Age: 18-64 years, 65+ years. Enrolment: 27.
Status: Ongoing, recruiting. Start date (EU): 2024-03-11. Decision date: 2024-10-10. Results received: No. Last updated: 2026-06-26.

Condition(s): Relapsed or refractory B-cell lymphoma
Product: Erbitux 5 mg/mL solution for infusion, TranspoCART19, Fludarabina Teva 25 mg/ml pulbere pentru soluţie injectabilă/perfuzabilă, RoActemra 20 mg/mL concentrate for solution for infusion, Genoxal 1.000 mg polvo para solución inyectable y para perfusión, Bendamustina Tillomed 2,5 mg/ml polvo para concentrado para solución para perfusión EFG

Primary endpoint: Phase 1: To determine the Recommended Phase II Dose (RP2D) and evaluate the safety of TranspoCART19 cell infusion based on the following parameters: The proportion of patients who develop cytokine release syndrome and/or neurological toxicity within the first month following administration of TranspoCART19, and the number of Grade III/IV adverse events related to the investigational drug, Phase II: To determine the efficacy of the TranspoCART19 cell infusion based on the following parameters: Best response rate achieved within 3 months after infusion (overall and complete). The Lugano Criteria will be used.
Endpoint(s): Procedure-related mortality (PRM) at 1 and 3 months, defined as any death not directly caused by lymphoma. For the estimation of MRP, disease relapse or progression will be considered as a competing event., Assessment of toxicity at 1 and 3 months, defined as number of grade II-IV adverse events using the CTC (Common Toxicity Criteria) version 5.0., Toxicity assessment at 1 and 3 years, defined as number of grade III-IV adverse events using the CTC (Common Toxicity Criteria) version 5.0.., Response rate (overall and complete) at one month, three months and one year. The Lugano criteria will be used., Best response rate achieved (overall and complete). The Lugano criteria will be used., Duration time of the overall response and of the complete response., Progression-free survival (PFS) at 1 and 2 years post-procedure, defined as the time between TranspoCART19 infusion and disease progression or death. Patients alive and in complete remission will be censored at the time of last follow-up., Overall survival (OS) at 1 and 2 years, defined as the time between TranspoCART19 infusion and death of the patient from any cause. Living patients will be censored at the time of last follow-up., In vivo survival of TranspoCART19 cells in peripheral blood, which will be determined by flow cytometry on a weekly basis for the first month, monthly for the first 6 months and quarterly thereafter until 2 years after infusion., Quality of life of the patients included, assessed by means of a questionnaire to be completed by patients or their legal guardians prior to treatment, at 3 and 6 months and one year after infusion.

Source: https://euclinicaltrials.eu/ctis-public/view/2024-514544-90-00